EU clinical trial 2024-516187-29-00: A randomised, double-blind, placebo-controlled trial to assess the effects of EP395 following an inhaled endotoxin challenge in healthy adults
Protocol code: EP395-006
Sponsor: EpiEndo Pharmaceuticals ehf. (Pharmaceutical company). Phase: Human Pharmacology (Phase I)- Other. Countries: Germany (ended).
Therapeutic area(s): Diseases [C] - Respiratory Tract Diseases [C08]
Gender: Female, Male. Age: 18-64 years. Enrolment: 65.
Status: Ended. Start date (EU): 2025-02-20. End date (EU): 2025-11-18. Decision date: 2024-11-15. Results received: No. Last updated: 2025-02-26.

Condition(s): Healthy volunteers [targeted indication: chronic obstructive pulmonary disease (COPD)]

Source: https://euclinicaltrials.eu/ctis-public/view/2024-516187-29-00